EU clinical trial 2024-513197-22-02: Adding oxygen to enhance antibiotic treatment of chronic lung infection
Sponsor: Rigshospitalet (Hospital/Clinic/Other health care facility). Phase: Human Pharmacology (Phase I)- Other. Countries: Denmark (authorised, recruitment pending).
Therapeutic area(s): Diseases [C] - Respiratory Tract Diseases [C08]; Analytical, Diagnostic and Therapeutic Techniques and Equipment [E] - Therapeutics [E02]; Diseases [C] - Bacterial Infections and Mycoses [C01]
Gender: Female, Male. Age: 18-64 years, 65+ years. Enrolment: 10.
Status: Authorised, recruitment pending. Decision date: 2024-09-13. Results received: No. Last updated: 2024-09-13.

Condition(s): Primary ciliary dyskinesia, Chronic pulmonary Pseudomonas aeruginosa infection, Cystic fibrosis

Source: https://euclinicaltrials.eu/ctis-public/view/2024-513197-22-02